EU clinical trial 2024-511653-22-00: A RANDOMIZED, PLACEBO-CONTROLLED, DOUBLE-BLIND STUDY OF ADJUVANT CEMIPLIMAB VERSUS PLACEBO AFTER SURGERY AND RADIATION THERAPY IN PATIENTS WITH HIGH RISK CUTANEOUS SQUAMOUS CELL CARCINOMA
Protocol code: R2810-ONC-1788
Sponsor: Regeneron Pharmaceuticals Inc. (Pharmaceutical company). Phase: Therapeutic confirmatory (Phase III). Countries: Ireland (ongoing, recruitment ended), Poland (ongoing, recruitment ended), France (ongoing, recruitment ended), Germany (ongoing, recruitment ended), Greece (ongoing, recruitment ended), Spain (ongoing, recruitment ended), Belgium (ongoing, recruitment ended), Italy (ongoing, recruitment ended).
Therapeutic area(s): Diseases [C] - Neoplasms [C04]
Gender: Female, Male. Age: 18-64 years, 65+ years. Enrolment: 76.
Status: Ongoing, recruitment ended. Start date (EU): 2020-02-12. Decision date: 2024-06-26. Results received: No. Last updated: 2026-07-16.
Decision dates by country: FR: 2024-06-26, GR: 2024-07-19, IE: 2024-06-26, ES: 2024-06-26, PL: 2024-07-23, BE: 2024-06-26, IT: 2024-07-01, DE: 2024-06-27

Condition(s): Cutaneous Squamous Cell Carcinoma (CSCC)
Product: matching Placebo with R2810, LIBTAYO 350 mg concentrate for solution for infusion.

Primary endpoint: DFS defined as time from randomization to the first documented disease recurrence (local, regional and/or distant); or death due to any cause.
Endpoint(s): Overall survival (OS), defined as time from randomization to the date of death., FFLRR defined as time from randomization to the date of first locoregional recurrence (LRR)., Freedom from distant recurrence (FFDR), defined as time from randomization to the date of first distant recurrence (DR). Patients who died without a preceding DR will be censored on the date of death., Cumulative occurrence of second primary cutaneous squamous cell carcinoma tumor (SPTs) for each patient from randomization to occurrence of first primary endpoint event or end of study., Safety, as measured by the incidence and severity of treatment-emergent adverse events (TEAE), deaths, and laboratory abnormalities., Cemiplimab concentrations in serum and immunogenicity as measured in ADA in serum

Source: https://euclinicaltrials.eu/ctis-public/view/2024-511653-22-00